EU clinical trial 2024-510782-42-00: EPIK-O: A Phase III, multi-center, randomized (1:1), open-label, active-controlled study to assess the efficacy and safety of alpelisib (BYL719) in combination with olaparib as compared to single agent cytotoxic chemotherapy, in participants with no germline BRCA mutation detected, platinum-resistant or refractory, high-grade serous ovarian cancer
Protocol code: CBYL719K12301
Sponsor: Novartis Pharma AG (Pharmaceutical company). Phase: Therapeutic confirmatory (Phase III). Countries: Germany (ended), Finland (ended), Spain (ended).
Therapeutic area(s): Diseases [C] - Neoplasms [C04]
Gender: Female. Age: 18-64 years, 65+ years. Enrolment: 14.
Status: Ended. Start date (EU): 2021-10-15. End date (EU): 2026-01-19. End date: 2026-01-20. Decision date: 2024-05-28. Results received: No. Last updated: 2025-12-23.
Decision dates by country: FI: 2024-05-30, DE: 2024-05-31, ES: 2024-05-28

Condition(s): Platinum-resistant or refractory, high-grade serous ovarian cancer with no germline BRCA mutation
Product: PACLITAXEL, ALPELISIB, DOXORUBICIN HYDROCHLORIDE, OLAPARIB, ALPELISIB, OLAPARIB

Primary endpoint: PFS based on BIRC assessment using RECIST 1.1 criteria
Endpoint(s): OS, Safety: Incidence, type and severity of adverse events per CTCAE v4.03 criteria including changes in laboratory values, vital signs, hepatic, renal and cardiac assessments. Tolerability: dose interruptions, reductions, dose intensity and duration of exposure for all drug components., Time to definitive deterioration of the ECOG performance status from baseline, Overall Response Rate (ORR) with confirmed response, Clinical Benefit Rate (CBR) with confirmed response, Duration Of Response (DOR) with confirmed response and Time To Response (TTR) (based on BIRC assessment using RECIST 1.1 criteria), Summary of statistics of PK parameters (including but not limited to AUCtau, AUClast, Cmax, Tmax) of alpelisib and olaparib (full PK subset only), Summary of statistics of plasma alpelisib and olaparib concentrations by time point., Change from baseline in Function Assessment of Cancer Therapy-Ovarian Trial Outcome Index (FACT-O)

Source: https://euclinicaltrials.eu/ctis-public/view/2024-510782-42-00